EU clinical trial 2024-514541-11-00: A randomized, double-blind, placebo-controlled clinical trial evaluating the efficacy and quality of life outcomes of Vi-Siblin in patients with low anterior resection syndrome following rectal cancer surgery.
Protocol code: Vi-SiTrial
Sponsor: Sykehuset Telemark HF (Hospital/Clinic/Other health care facility). Phase: Therapeutic exploratory (Phase II). Countries: Norway (authorised, recruitment pending).
Therapeutic area(s): Diseases [C] - Pathological Conditions, Signs and Symptoms [C23]; Diseases [C] - Digestive System Diseases [C06]
Gender: Female, Male. Age: 18-64 years, 65+ years. Enrolment: 120.
Status: Authorised, recruitment pending. Decision date: 2026-04-27. Results received: No. Last updated: 2026-04-27.

Condition(s): Low anterior resection syndrome after low anterior resection for rectal cancer
Product: Placebo powder will be produced according to tabel 1.2 in the IMPD-Q, Vi-Siblin granulat

Primary endpoint: Total LARS score 8 weeks after start of treatment
Endpoint(s): HRQoL scores 8 weeks after start of treatment, Time (in weeks) from initiation of treatment to first clinically relevant improvement in LARS score, LARS scores and its items at baseline and after 8 weeks of treatment

Source: https://euclinicaltrials.eu/ctis-public/view/2024-514541-11-00